EU clinical trial 2024-511997-66-00: Trial Examining Methods for Antidepressant Discontinuation (TEMPO)
Sponsor: Amsterdam UMC Stichting (Hospital/Clinic/Other health care facility). Phase: Therapeutic use (Phase IV). Countries: Netherlands (ongoing, recruitment ended).
Therapeutic area(s): Psychiatry and Psychology [F] - Mental Disorders [F03]
Gender: Female, Male. Age: 18-64 years, 65+ years. Enrolment: 200.
Status: Ongoing, recruitment ended. Start date (EU): 2024-11-22. Decision date: 2024-11-22. Results received: No. Last updated: 2025-04-24.

Condition(s): Major Depressive Disorder
Product: PAROXETINE, VENLAFAXINE

Primary endpoint: Rate of failure to successfully discontinue antidepressant: defined as significant deviation from discontinuation antidepressant protocol (e.g. switching to rescue medication (≥5 days in total), stopping with discontinuation medication) or significant withdrawal symptoms (increase in modified 15-item DESS from baseline ≥4 for ≥2 consecutive assessments) during Phase II.

Source: https://euclinicaltrials.eu/ctis-public/view/2024-511997-66-00